EU clinical trial 2024-512733-32-00: HOVON 177: Randomized study to assess revumenib in combination with azacitidine + venetoclax in adult patients with newly diagnosed NPM1 mutated or KMT2A rearranged AML ineligible for intensive chemotherapy
Protocol code: HOVON-177 AML
Sponsor: Hemato-Oncologie voor Volwassenen Nederland (Hovon) Stichting (Hospital/Clinic/Other health care facility). Phase: Therapeutic confirmatory (Phase III). Countries: Germany (ongoing, recruiting), Netherlands (ongoing, recruiting), Austria (authorised, recruiting), Belgium (ongoing, recruiting), Denmark (authorised, recruiting), Estonia (authorised, recruiting), Finland (ongoing, recruiting), France (ongoing, recruiting), Ireland (ongoing, recruiting), Italy (ongoing, recruiting), Lithuania (ongoing, recruiting), Spain (ongoing, recruiting), Sweden (ongoing, recruiting), Norway (authorised, recruiting).
Therapeutic area(s): Diseases [C] - Neoplasms [C04]
Gender: Female, Male. Age: 18-64 years, 65+ years. Enrolment: 323.
Start date (EU): 2025-03-31. Decision date: 2025-03-03. Results received: No. Last updated: 2026-05-20.
Decision dates by country: DK: 2025-06-30, IT: 2025-07-31, FR: 2025-07-21, EE: 2025-07-10, IE: 2025-07-11, BE: 2025-07-07, SE: 2025-07-03, NL: 2025-03-03, NO: 2025-07-14, LT: 2025-07-30, ES: 2025-08-08, AT: 2025-07-14, FI: 2025-07-07, DE: 2025-03-04

Condition(s): Acute Myeloid Leukemia (AML)
Product: Revumenib, Placebo for revumenib 160mg, Venclyxto 50 mg film-coated tablets, Revumenib, Revumenib, Placebo for revumenib 110mg, Placebo for revumenib 25mg, Azacitidine Seacross 25 mg/mL powder for suspension for injection, Venclyxto 100 mg film-coated tablets, Venclyxto 10 mg film-coated tablets

Primary endpoint: OS in adult patients with newly diagnosed NPM1-mutated AML ineligible for intensive chemotherapy, measured from the date of randomization to the date of death from any cause; Rate of CR in adult patients with newly diagnosed NPM1-mutated AML ineligible for intensive chemotherapy, defined as the proportion of NPM1-mutated AML patients who achieve CR at any time-point during protocol therapy.
Endpoint(s): EFS in adult patients with newly diagnosed NPM1-mutated AML ineligible for intensive chemotherapy, measured from the date of randomization to the date of treatment failure, hematologic relapse from CR/CRh or death from any cause, whichever occurs first. Treatment failure is defined as lack of obtaining either CR or CRh by week 24, Rate of CR/CRh in adult patients with newly diagnosed NPM1-mutated AML ineligible for intensive chemotherapy, defined as the proportion of NPM1-mutated AML patients who achieve CR or CRh at any time-point during protocol therapy., Rate of response (CRh and CR/CRi) in adult patients with newly diagnosed NPM1-mutated AML ineligible for intensive chemotherapy, defined as the proportion of NPM1-mutated AML patients with response at any time-point during protocol therapy., Rates of CRMRD-, CR/CRhMRD- and CR/CRiMRD- assessed by quantitative PCR of bone marrow in adult patients with newly diagnosed NPM1-mutated AML ineligible for intensive chemotherapy, defined as the proportion of NPM1-mutated AML patients with CRMRD-, CR/CRhMRD- and CR/CRiMRD- by PCR in bone marrow, respectively, at any time-point during protocol therapy., Time to achievement of response (CR, CR/CRh and CR/CRi) in adult patients with newly diagnosed NPM1-mutated AML ineligible for intensive chemotherapy, defined as time from the date of randomization to until the 1st occurrence of the response., Duration of response (CR, CR/CRh and CR/CRi; DoR) in adult patients with newly diagnosed NPM1-mutated AML ineligible for intensive chemotherapy, measured from the date of achievement of response until the date of hematologic relapse or death from any cause; patients without any of these events will be censored on the date of the last clinical assessment., OS, CR rate, EFS, rates of CR, CR/CRh, CR/CRi, and DoR across different patient subgroups in adult patients with newly diagnosed NPM1-mutated AML ineligible for intensive chemotherapy, where the groups are defined based on prognostic variables including clinical variables (e.g., age at randomization, sex, ECOG performance status, white blood cell count), risk category, geographical region as well as specific AML genotypes., Rates of CRMRD, CR/CRhMRD- and CR/CRiMRD- assessed by multiparameter flowcytometry of bone marrow at any time-point during protocol therapy in adult patients with newly diagnosed NPM1-mutated AML ineligible for intensive chemotherapy, defined as the proportion of NPM1-mutated AML patients with CRMRD-, CR/CRhMRD- and CR/CRiMRD- by multiparameter flowcytometry, respectively, at any time-point during protocol therapy., Resistance mechanisms after combined treatment with azacitidine/venetoclax/revumenib (e.g. MEN1 mutations, RAS mutations, TP53 mutations, FLT3 mutations)., Quality of life (QoL) in adult patients with newly diagnosed NPM1-mutated AML ineligible for intensive chemotherapy as assessed by EORTC QLC-C30 and EQ-5D-5L questionnaires., OS, CR rate, EFS, rates of CR/CRh, CR/CRi, CRMRD-, CR/CRhMRD-, CR/CRiMRD-, time to response, DoR and QoL as assessed by EORTC QLQ-C30 and EQ-5D-5L questionnairesas defined above in adult patients with newly diagnosed KMT2A-rearranged AML ineligible for intensive chemotherapy., Descriptive summary of plasma concentrations and PK parameters of revumenib and the primary metabolites., Descriptive summary of revumenib pharmacodynamics in relation to safety, efficacy and correlative biomarkers, which may include immunophenotyping of circulating peripheral blood mononuclear cells (PBMC) and/or bone marrow, gene expression, mutational analysis, and minimal residual disease (MRD)., Frequency and severity of AE according to CTCAE version 5.0., Time to hematopoietic recovery (absolute neutrophil counts ≥0.5 and ≥1.0 x 109/L; platelets ≥50 and ≥100 x 109/L) after each treatment cycle (but at least for each of the first 6 cycles), defined as the time from the start of the cycle until recovery., Number of patients requiring transfusions (platelet and RBC) and number of units transfused, rate and duration of transfusion independence, length of hospital stay, where transfusion independence is defined as a period of at least 56 days with no transfusion between the first dose of study drug and the last dose of study drug + 30 days., Rates of CRMRD-, CR/CRhMRD-, and CR/CRiMRD- assessed by quantitative PCR of peripheral blood in adult patients with newly diagnosed NPM1-mutated AML ineligible for intensive chemotherapy, defined as the proportion of NPM1-mutated AML patients with CRMRD-, CR/CRhMRD- and CR/CRiMRD- by PCR in peripheral blood, respectively, at any time-point during protocol therapy.

Source: https://euclinicaltrials.eu/ctis-public/view/2024-512733-32-00